EU clinical trial 2023-509182-21-00: An exploratory, randomized, double-blind, multicentre, placebo-controlled study of RTP-026 to assess safety, tolerability, and efficacy in patients with ST-Elevation Myocardial Infarction (STEMI)
Sponsor: ResoTher Pharma A/S (Pharmaceutical company). Phase: Therapeutic exploratory (Phase II). Countries: Denmark (ongoing, recruitment ended), Sweden (ongoing, recruitment ended).
Therapeutic area(s): Diseases [C] - Cardiovascular Diseases [C14]
Gender: Female, Male. Age: 18-64 years, 65+ years. Enrolment: 91.
Status: Ongoing, recruitment ended. Start date (EU): 2024-09-16. Decision date: 2024-05-02. Results received: No. Last updated: 2026-07-06.
Decision dates by country: DK: 2024-05-02, SE: 2025-11-24

Condition(s): Patients with ST-Elevation Myocardial Infarction (STEMI)
Product: RTP-026, RTP-026 Placebo

Primary endpoint: The primary safety endpoint: To compare the safety and tolerability of RTP-026 against placebo by evaluating adverse events (AEs), serious adverse events (SAEs), vital signs, ECGs, and laboratory abnormalities., To compare the effect of RTP-026 against placebo by assessing the following by treatment group: Change in cTnT and CK-MB determined in samples taken at Baseline, 6 hrs, 12 hrs and 24 hours post-PCI
Endpoint(s): Initial MSI defined as the ratio between IS and AAR determined within 48 hours post-PCI determined by CMR, MSI determined by CMR 90 days post-PCI, IS determined by CMR within 48 hours post-PCI, IS determined by CMR 90 days post-PCI, Myocardial oedema determined by CMR within 48 hours post-PCI, Change in IS from initial determination of IS within 48 hours post-PCI to 90 days post-PCI determined by CMR, Effects on LVEF determined by CMR 48 hours post-PCI, Effects on LVEF determined by CMR 90 days post-PCI, Changes in Pro-BNP, hsCRP and NLR determined in samples taken at Baseline, 6 hrs, 12 hrs and 24 hours post-PCI, The composite of death and MACE (defined as CV mortality, admission due to recurrent AMI or HF up to day 28 post-PCI, The composite of death and MACE up to day 90 post-PCI, Days to discharge from hospital

Source: https://euclinicaltrials.eu/ctis-public/view/2023-509182-21-00